EU clinical trial 2024-512682-14-00: A randomized, 2-arm non-comparative phase II study on the efficacy of atezolizumab and Roche bevacizumab (Atezo/Bev) followed by on-demand selective TACE (sdTACE) upon detection of disease progression or of initial synchronous treatment with TACE and Atezo/Bev on objective response rate in the treatment of unresectable hepatocellular carcinoma patients (DEMAND)
Protocol code: AIO-HEP-0418-DEMAND
Sponsor: Klinikum der Universitaet Muenchen AöR (Hospital/Clinic/Other health care facility). Phase: Therapeutic exploratory (Phase II). Countries: Germany (ongoing, recruitment ended).
Therapeutic area(s): Diseases [C] - Neoplasms [C04]
Gender: Female, Male. Age: 18-64 years, 65+ years. Enrolment: 100.
Status: Ongoing, recruitment ended. Start date (EU): 2020-04-06. Decision date: 2024-10-08. Results received: No. Last updated: 2026-07-10.

Condition(s): Non-resectable hepatocellular carcinoma (HCC)
Product: Avastin 25 mg/ml concentrate for solution for infusion., Tecentriq 1 200 mg concentrate for solution for infusion

Primary endpoint: To evaluate the efficacy of up-front atezolizumab/ bevacizumab (Atezo/Bev) followed by on-demand selective transarterial chemoembolization (sdTACE) and of initial synchronous treatment with TACE and Atezo/Bev in the treatment of unresectable HCC patients Corresponding primary endpoint: Objective response rate (according to RECIST v1.1) (as assessed by local investigator) (ORR)
Endpoint(s): To evaluate the efficacy, safety and quality of life of treatment with Atezo/Bev in combination with TACE Corresponding secondary endpoints:• Overall survival (OS) • 24-months survival rate • Progression-free survival (PFS) • Complete response rate (CRR) • Disease control rate (DCR) • Time to deterioration of liver function, defined as time from randomization to worsening of CTCAE grade compared with baseline and persisting for ≥ 30 days for any of these parameters: aspartate aminotransferas

Source: https://euclinicaltrials.eu/ctis-public/view/2024-512682-14-00